EU clinical trial 2024-519658-35-00: Open-label clinical phase 1/2 study to assess the safety and efficacy of the SpectraCure P18 System and verteporfin for injection for the treatment of primary localized prostate cancer
Protocol code: SPC11-02-110
Sponsor: SpectraCure AB (publ) (Pharmaceutical company). Phase: Phase I and Phase II (Integrated)- Other. Countries: Germany (authorised, recruitment pending).
Therapeutic area(s): Diseases [C] - Neoplasms [C04]
Gender: Male. Age: 18-64 years, 65+ years. Enrolment: 20.
Status: Authorised, recruitment pending. Decision date: 2025-05-19. Results received: No. Last updated: 2025-12-05.

Condition(s): Primary localised prostate cancer
Product: Visudyne 15 mg powder for solution for infusion, CIPROFLOXACIN

Primary endpoint: Safety: Assessment of toxicity according to CTCAE v5.0 related to therapy per protocol. In addition, any PDT-mediated severe damage to the periprostatic tissues will be evaluated by MRI images obtained 5-9 days post-PDT. The threshold for success is anticipated to be no Grade 3 toxicity to the rectum or bladder assessed on MRI or any drug-related Serious Adverse Events.
Endpoint(s): Device performance: Light dose coverage >90% of the target volume evaluated by dose-volume histograms in >80% of subjects., Adequacy of effectiveness: Extent of quantifiable treatment effect in the prostate evaluated by MRI one-week post-PDT by calculating the percentage of necrosis evaluated by MRI. Descriptive statistics will be presented for each subject., Efficacy: Percentage of subjects with negative in-field biopsies (histopathologically tumour free) at 6 months. A proportion of subjects with negative biopsies of 0.75 at 6 months in phase 2 is expected and is considered clinically meaningful. The rate of negative in-field biopsy at 6 and 18 months as defined by the Delphi consensus criterion (≤ 3 mm of Gleason ≤ 6 disease in any biopsy core is insignificant).

Source: https://euclinicaltrials.eu/ctis-public/view/2024-519658-35-00